EU clinical trial 2024-516906-47-00: A Randomized, Open-Label, Phase 2/3 Study of Datopotamab Deruxtecan (Dato-DXd) plus Carboplatin or Cisplatin versus Gemcitabine plus Carboplatin or Cisplatin in Participants with Locally Advanced or Metastatic Urothelial Carcinoma (la/mUC) who Progressed During or After Enfortumab Vedotin (EV) plus Pembrolizumab Combination Treatment. TROPION-Urothelial03 (TU03).
Protocol code: DS1062-328
Sponsor: Daiichi Sankyo Inc. (Pharmaceutical company). Phase: Phase II and Phase III (Integrated). Countries: Netherlands (authorised, recruitment pending), Germany (ongoing, recruiting), Norway (authorised, recruitment pending), Denmark (authorised, recruitment pending), France (ongoing, recruiting), Austria (ongoing, recruiting), Italy (authorised, recruitment pending), Spain (authorised, recruitment pending), Belgium (authorised, recruitment pending), Czechia (authorised, recruitment pending), Greece (authorised, recruitment pending).
Therapeutic area(s): Diseases [C] - Neoplasms [C04]
Gender: Female, Male. Age: 18-64 years, 65+ years. Enrolment: 341.
Start date (EU): 2025-11-28. Decision date: 2025-10-15. Results received: No. Last updated: 2026-04-29.
Decision dates by country: IT: 2025-10-17, NO: 2025-10-15, NL: 2025-10-16, BE: 2026-02-02, CZ: 2026-02-17, GR: 2026-01-12, FR: 2025-10-17, DE: 2025-10-17, AT: 2025-10-20, DK: 2025-10-15, ES: 2025-10-20

Condition(s): Locally Advanced or Metastatic Urothelial Carcinoma
Product: Carboplatin Hikma 10 mg/ml Konzentrat zur Herstellung einer Infusionslösung, Ribozar 1 g Pulver zur Herstellung einer Infusionslösung, Datopotamab deruxtecan, Cisplatin Hikma 1 mg/ml Konzentrat zur Herstellung einer Infusionslösung

Primary endpoint: Phase 2: ORR, assessed by investigator assessment using RECIST Version 1.1 criteria: defined as the proportion of participants with a BOR of confirmed CR or confirmed PR., Phase 3: PFS, determined by BICR assessment of tumor scans and using RECIST Version 1.1 criteria, defined as the time from randomization to the first documented radiographic disease progression or death due to any cause, whichever occurs first., Phase 3: OS, defined as the time from randomization to death due to any cause.
Endpoint(s): Phase 2: DoR, assessed by investigator assessment using RECIST Version 1.1 criteria, defined as the time from the date of first documentation of objective tumor response (confirmed CR or confirmed PR) to the date of the first documented radiographic disease progression or death due to any cause, whichever occurs first in responding participants., Phase 2: PFS, determined by investigator assessment of tumor scans and using RECIST Version 1.1 criteria, defined as the time interval from the date of randomization to the first documented radiographic disease progression or death due to any cause, whichever occurs first., Phase 2: OS is defined as the time from randomization to death due to any cause., Phase 2: TTR, assessed by investigator assessment using RECIST Version 1.1 criteria, defined as the time from randomization to the date of the first documentation of objective tumor response (confirmed CR or confirmed PR) in responding participants., Phase 2: DCR, assessed by investigator assessment using RECIST Version 1.1 criteria, is defined as proportion of participants with a BOR of confirmed CR, confirmed PR, or SD., Phase 2: Incidence of TEAEs, SAEs, AESIs, deaths, and changes from baseline in vital signs, standard clinical laboratory parameters, ECG parameters, ECHO/MUGA scan findings, and ophthalmologic findings., Phase 2: ADA incidence., Phase 2: Characterize population PK of Dato-DXd and DXd and the relationship between exposure and efficacy and safety endpoints., Phase 3: PFS, determined by investigator assessment of tumor scans and using RECIST Version 1.1 criteria, is defined as the time interval from the date of randomization to the first documented radiographic disease progression or death due to any cause, whichever occurs first., Phase 3: ORR, assessed by BICR and investigator assessment using RECIST Version 1.1 criteria, is defined as the proportion of participants with a BOR of confirmed CR or confirmed PR., Phase 3: DoR, assessed by BICR and investigator assessment using RECIST Version 1.1 criteria, is defined as the time from the date of first documentation of objective tumor response (confirmed CR or confirmed PR) to the date of the first documented radiographic disease progression or death due to any cause, whichever occurs first in responding participants., Phase 3: TTR, assessed by BICR and investigator assessment using RECIST Version 1.1 criteria, is defined as the time from randomization to the date of the first documentation of objective tumor response (confirmed CR or confirmed PR) in responding participants., Phase 3: DCR, assessed by BICR and investigator assessment using RECIST Version 1.1 criteria, is defined as proportion of participants with a BOR of confirmed CR, confirmed PR, or SD., Phase 3: Incidence of TEAEs, SAEs, AESIs, deaths, and changes from baseline in vital signs, standard clinical laboratory parameters, ECG parameters, ECHO/MUGA scan findings, and ophthalmologic findings., Phase 3: ADA incidence., Phase 3: TTCD, defined as time from the date of randomization to the date of confirmed deterioration, and mean change from baseline in the urinary symptoms subscale of the EORTC-QLQ-BLM30., Phase 3: TTCD, defined as time from the date of randomization to the date of confirmed deterioration, and mean change from baseline in GHS/QoL, as measured by the GHS/QoL scale from EORTC-QLQ-C30., Phase 3: TTCD, defined as time from the date of randomization to the date of confirmed deterioration, and mean change from baseline in physical and role functioning, as measured by the physical functioning and role functioning domains from EORTC-QLQ-C30.

Source: https://euclinicaltrials.eu/ctis-public/view/2024-516906-47-00